EU clinical trial 2023-505211-21-00: A Phase II, Randomized, Multicenter, Double-Blind, Controlled Study of Tobemstomig Plus Platinum-Based Chemotherapy versus Pembrolizumab Plus Platinum-Based Chemotherapy in Patients with Previously Untreated Locally Advanced or Metastatic Non-Small Cell Lung Cancer
Protocol code: BO44178
Sponsor: F. Hoffmann-La Roche AG (Pharmaceutical company). Phase: Therapeutic exploratory (Phase II). Countries: Italy (ended), Germany (ended), Spain (ended), Belgium (ended), France (ended).
Therapeutic area(s): Diseases [C] - Neoplasms [C04]
Gender: Female, Male. Age: 18-64 years, 65+ years. Enrolment: 81.
Status: Ended. Start date (EU): 2023-03-10. End date (EU): 2026-06-10. End date: 2026-06-11. Decision date: 2024-03-01. Results received: No. Last updated: 2026-07-10.
Decision dates by country: ES: 2024-03-01, DE: 2024-03-05, BE: 2024-03-18, FR: 2024-03-04, IT: 2024-03-06

Condition(s): Previously untreated locally advanced or metastatic non-small cell lung cancer (NSCLC)

Primary endpoint: 1. PFS after randomization, defined as the time from randomization to the first occurrence of disease progression or death from any cause (whichever occurs first), as determined by the investigator according to RECIST v1.1, 2. ORR, defined as the proportion of participants with a complete response or a partial response on two consecutive occasions ≥ 4 weeks apart, as determined by the investigator according to RECIST v1.1
Endpoint(s): 1. OS after randomization, defined as the time from randomization to death from any cause, 2. Duration of response for participants with confirmed objective response, defined as the time from the first occurrence of a confirmed objective response to disease progression or death from any cause (whichever occurs first), as determined by the investigator according to RECIST v1.1, 3. PFS and OS in participants with PD-L1 expression, defined as tumor cells < 1%, 1%-49%, and < 50%, as assessed by retrospective central PD-L1 testing, 4. Change from baseline to Week 12 in patient-reported outcomes of lung cancer symptoms, physical functioning, role functioning, and global health status/quality of life, as assessed through the use of the European Organisation for Research and Treatment of Cancer Item Libraries, 5. Incidence and severity of adverse events, with severity determined according to the National Cancer Institute Common Terminology Criteria for Adverse Events, Version 5.0 The severity of cytokine release syndrome will also be determined according to the American Society for Transplantation and Cellular Therapy Consensus Grading Scale., 6. Maximum concentration of tobemstomig, 7. Time of maximum concentration of tobemstomig, 8. Clearance of tobemstomig, 9. Volume of distribution at steady state of tobemstomig, 10. Area under the concentration-time curve tobemstomig, 11. Half‑life of tobemstomig, 12. Concentrations of tobemstomig in serum at specified timepoints, 13.Prevalence of ADAs to tobemstomig at baseline and incidence of ADAs to tobemstomig during the study

Source: https://euclinicaltrials.eu/ctis-public/view/2023-505211-21-00